EU clinical trial 2022-500108-23-00: The influence of tramadol on opioid-induced bowel dysfunction
Sponsor: Aalborg University Hospital (Hospital/Clinic/Other health care facility). Phase: Therapeutic use (Phase IV). Countries: Denmark (ended).
Therapeutic area(s): Diseases [C] - Digestive System Diseases [C06]
Gender: Male. Age: 18-64 years. Enrolment: 20.
Status: Ended. Start date (EU): 2022-08-08. End date (EU): 2023-05-15. Decision date: 2022-05-31. Results received: Yes. Last updated: 2023-02-13.

Condition(s): Opioid induced bowel dysfunction
Product: TRAMADOL, Placebotablet 10mm

Primary endpoint: To evaluate total gastrointestinal transit time (MTS-2), To evaluate colorectal transit time
Endpoint(s): Subjective assessments of constipation (PAC-SYM, BSFS, GSRS, BFI), Diagnostic evaluation of opioid-induced constipation (Rome IV C6), Subjective assessment of opiate withdrawal (SOWS), Segmental transit time of the stomach, small intestine, and colonic segments (assessed with MTS-2), Detailed colonic motility (assessed with MTS-2), Colon volume (assessed with MRI), Water content in the colon (assessed with MRI), Gastric half emptying time (assessed with MRI), Gastric accommodation (assessed with MRI), Gastric motility (assessed with MRI), Small bowel motility (assessed with MRI), Small bowel water content (assessed with MRI)

Source: https://euclinicaltrials.eu/ctis-public/view/2022-500108-23-00